EU clinical trial 2025-522530-31-01: PASSION (olaParib mAintenance in chemotherapy-Sensitive metaStatic pancreatIc adenOcarciNoma - mPDAC): a phase II, proof of principle, study
Protocol code: PASSION
Sponsor: Universita' Degli Studi Di Verona (Educational Institution). Phase: Therapeutic exploratory (Phase II). Countries: Italy (authorised, recruiting).
Therapeutic area(s): Diseases [C] - Neoplasms [C04]
Gender: Female, Male. Age: 18-64 years, 65+ years. Enrolment: 37.
Status: Authorised, recruiting. Start date (EU): 2026-02-27. Decision date: 2026-01-26. Results received: No. Last updated: 2026-02-17.

Condition(s): Patients with metastatic PDAC, who have not progressed following completion of at least 16 weeks (can be more) of any multiagent first-line chemotherapy
Product: Lynparza 150 mg film-coated tablets, Lynparza 100 mg film-coated tablets

Primary endpoint: Overall Survival (OS) rate at 12 months after starting olaparib maintenance (OS@12-mo).
Endpoint(s): OS (observed and predicted using observed Progression-Free Survival - PFS - and OS data) from both first-line chemotherapy and olaparib treatment start., Time to first progression from olaparib treatment start, using modified RECIST 1.1 criteria (PFS1)., PFS from first-line chemotherapy treatment start, using RECIST 1.1 criteria., Time to second progression from olaparib treatment start (PFS2)., Objective Response Rate (ORR) to olaparib using modified RECIST 1.1 criteria for evaluable patients., Disease Control Rate at 24 weeks from olaparib treatment start using modified RECIST 1.1 criteria OS/PFS/ORR/DCR in Cohorts A and B., OS/PFS/ORR/DCR in Cohorts A and B ; a futility analysis will be performed to terminate enrolment in cohort B, if PFS@6m is not satisfactory in that cohort (g/sHRD mutation-negative or unknown)., Adjusted mean change from baseline in global QoL score from the EORTC-QLQ-C30 and questionnaire and PAN26 symptom scales and items [pain, fatigue, nausea, weight loss (difficulty gaining weight/loss of appetite), jaundice]., Safety: Incidence and severity of adverse events (AE) according to NCI-CTCAE v5.0., Exploratory: OS/PFS/ORR/DCR/HR-QoL in patients who have received a non-platinum containing first-line regimen., Exploratory: Correlation between specific HR-related gene alterations and disease/treatment-related outcomes (OS/PFS/ORR/DCR)., Exploratory: Correlation between HRD signature(s) in tumour tissue and disease/treatment-related outcomes (OS/PFS/ORR/DCR)., Exploratory: Correlation between functional testing based on the detection of RAD51 foci and disease/treatment-related outcomes (OS/PFS/ORR/DCR).

Source: https://euclinicaltrials.eu/ctis-public/view/2025-522530-31-01